EU clinical trial 2024-518842-26-00: TremelImumab aNd durvalumab combination For the non-operatIve management (NOM) of Microsatellite InstabiliTY (MSI)-high resectable gastric or gastroesophageal junction cancer: The multicentre, single-arm, multi-cohort, Phase II INFINITY study.
Protocol code: INFINITY
Sponsor: Fondazione GONO G.I. (Patient organisation/association). Phase: Therapeutic exploratory (Phase II). Countries: Italy (ongoing, recruitment ended).
Therapeutic area(s): Diseases [C] - Neoplasms [C04]
Gender: Female, Male. Age: 18-64 years, 65+ years. Enrolment: 31.
Status: Ongoing, recruitment ended. Start date (EU): 2025-01-21. Decision date: 2025-01-21. Results received: No. Last updated: 2026-06-03.

Condition(s): Cancer in the stomach or in the junction between the stomach and the oesophagus, without metastases in other organs and surgically resectable, with microsatellite instability and no EBV infection.
Product: TREMELIMUMAB, DURVALUMAB

Primary endpoint: Cohort 1: Pathological complete response (ypT0N0) and negative ctDNA status after neoadjuvant immunotherapy in the intention-to-treat population. Cohort 2: 2-year complete response rate, defined as the absence of macroscopic or microscopic residual disease (locally, regionally and distantly) at radiological examinations, tissue and liquid biopsy, in absence of salvage gastrectomy.
Endpoint(s): 3-year disease-free survival, defined as time from the enrollment in the study to the occurrence of disease relapse (local and/or distant), second GC/GEJC primary, or death from any cause., 5-year overall survival, defined as time from the enrollment in the study to the occurrence of death., Metastases-free survival, defined as time from the enrollment in the study to the first evidence of metastases or death from any cause., Gastrectomy-free survival (for Cohort 2 only), defined as time from the enrollment in the study to the occurrence of gastrectomy or death from any cause.

Source: https://euclinicaltrials.eu/ctis-public/view/2024-518842-26-00